EU clinical trial 2022-500678-33-00: PLATFORM-COVID study; Platform randomised trial of treatments for COVID-19 in general practice
Protocol code: NL79504.068.21
Sponsor: Maastricht University. Phase: Therapeutic use (Phase IV). Countries: Netherlands (not authorised).
Therapeutic area(s): Diseases [C] - Virus Diseases [C02]
Gender: Female, Male. Age: 18-64 years, 65+ years. Enrolment: 1200.
Status: Not authorised. Decision date: 2022-07-28. Results received: No. Last updated: 2022-07-28.

Condition(s): Patients with COVID-19 in the community, referred by their general practitioner, who are at higher risk of a complicated illness course.
Product: MONTELUKAST SANDOZ 10 MG, FILMOMHULDE TABLETTEN

Primary endpoint: The primary endpoint is time to recovery from suspected COVID-19 infection within 28 days from randomisation, defined as the first instance that a participant reports feeling recovered. This will be measured by means of a daily diary, where the participant records the answer to the question 'Do you feel fully recovered today? (i.e. symptoms associated with illness are no longer a problem)' with either yes or no.
Endpoint(s): Secondary outcomes include: hospital admission; hospital assessment without admission; oxygen administration; intensive care unit admission; duration of severe symptoms; sustained recovery; contacts with the health services; consumption of antibiotics; WHO Well-being Index; daily rating of how well participants feels; Safety; Death

Source: https://euclinicaltrials.eu/ctis-public/view/2022-500678-33-00